EU clinical trial 2024-512571-12-00: Oil- versus water-based contrast media for hysterosalpingography (HSG) in infertile women with unevaluated indications: a randomized controlled trial (H2Oil-2 study)
Protocol code: NL66079.029.18
Sponsor: Amsterdam UMC Stichting (Hospital/Clinic/Other health care facility). Phase: Therapeutic use (Phase IV). Countries: Netherlands (ended).
Therapeutic area(s): Diseases [C] - Female Urogenital Diseases and Pregnancy Complications [C13]
Gender: Female. Age: 18-64 years. Enrolment: 499.
Status: Ended. Start date (EU): 2024-11-29. End date (EU): 2026-01-19. Decision date: 2024-11-29. Results received: No. Last updated: 2024-11-29.

Condition(s): Infertility
Product: VISIPAQUE 320 mg I/ml, oplossing voor injectie, Lipiodol Ultra Fluide, 480 mg I/ml, oplossing voor injectie.

Primary endpoint: The primary outcome is conception leading to live birth, with a positive pregnancy test preceding the pregnancy within 6 months after randomization.
Endpoint(s): Biochemical pregnancy, Clinical pregnancy, Ongoing pregnancy, Miscarriage, Ectopic pregnancy, Multiple pregnancy, Time to pregnancy, Complications following HSG (infection, intravastion), Pregnancy outcomes (f.e. birth weight), Pregnancy complications, Stillbirth, Thyroid function of the woman (before and 1 month after HSG), Neonatal outcomes, Additional fertility treatments (Intra-uterine insemination, IVF, IVF/ICSI), Costs within 6 months after randomization, Thyroid function of neonate (determined by heelprick)

Source: https://euclinicaltrials.eu/ctis-public/view/2024-512571-12-00